EU clinical trial 2023-503382-29-00: ILLUMINATE-C: A Single Arm Study to Evaluate Efficacy, Safety, Pharmacokinetics, and Pharmacodynamics of Lumasiran in Patients with Advanced Primary Hyperoxaluria Type 1 (PH1)
Protocol code: ALN-GO1-005
Sponsor: Alnylam Pharmaceuticals Inc. (Pharmaceutical company). Phase: Therapeutic confirmatory (Phase III). Countries: France (ended), Netherlands (ended), Belgium (ended), Italy (ended).
Therapeutic area(s): Diseases [C] - Nutritional and Metabolic Diseases [C18]
Gender: Female, Male. Age: 0-17 years, 18-64 years. Enrolment: 7.
Status: Ended. Start date (EU): 2020-01-20. End date (EU): 2025-06-23. End date: 2025-06-24. Decision date: 2023-05-25. Results received: Yes. Last updated: 2025-05-05.
Decision dates by country: FR: 2023-05-31, NL: 2023-05-25, BE: 2023-07-03, IT: 2023-07-07

Condition(s): Primary Hyperoxaluria Type 1 (PH1)
Product: Oxlumo 94.5 mg/0.5 mL solution for injection.

Primary endpoint: Cohort A: Percent change in plasma oxalate from Baseline to Month 6, Cohort B: Percent change in plasma oxalate from Baseline to Month 6
Endpoint(s): Primary Analysis Period (Baseline to 6 months): Percent change in plasma oxalate AUC between dialysis sessions (Cohort B), Absolute change in plasma oxalate, Change in the following parameters: *Urinary oxalate measured by percent and absolute change in 24-hour urinary oxalate excretion corrected for body surface area (BSA) and spot urinary oxalate:creatinine ratio, when available *QoL assessed by the PedsQL Total Score for patients ≥2 to <18 years of age at consent, and as assessed by KDQOL Burden of Kidney Disease and Effect of Kidney Disease on Daily Life subscales, and SF-12 Physical Component Summary and Mental Component Summary, in patients ≥18, Plasma PK parameters of lumasiran, Percent change in plasma oxalate AUC between dialysis sessions (Cohort B), Percent and absolute change in plasma oxalate, Change in the following parameters: *Nephrocalcinosis as assessed by renal ultrasound; *Frequency and mode of dialysis (Cohort B); *Frequency of renal stone events; *Urinary oxalate measured by 24-hour urinary oxalate excretion corrected for BSA, and spot urinary oxalate:creatinine ratio; *Renal function as assessed by estimated glomerular filtration rate (eGFR) (Cohort A); *Measures of systemic oxalosis in the following systems: -Cardiac -Skeletal -Ocular; *QoL(Quality of life) assessed

Source: https://euclinicaltrials.eu/ctis-public/view/2023-503382-29-00